EU clinical trial 2025-521602-18-00: Efficacy and safety of Remimazolam compared to Ketamine and Propofol in Rapid Sequence Induction. A monocentric pilot randomised-controlled study
Protocol code: RC25_0093
Sponsor: Centre Hospitalier Universitaire De Nantes (Hospital/Clinic/Other health care facility). Phase: Therapeutic exploratory (Phase II). Countries: France (authorised, recruitment pending).
Therapeutic area(s): Analytical, Diagnostic and Therapeutic Techniques and Equipment [E] - Anesthesia and Analgesia [E03]
Gender: Female, Male. Age: 18-64 years, 65+ years. Enrolment: 90.
Status: Authorised, recruitment pending. Decision date: 2026-01-06. Results received: No. Last updated: 2026-01-06.

Condition(s): Rapid Sequence Induction in operating room
Product: PROPOFOL, KETAMINE, Byfavo 20 mg powder for solution for injection

Primary endpoint: proportion of patient with successful intubation at first attempt
Endpoint(s): In the operating theatre (within 5 minutes after induction of anesthesia) compared between the three study groups:median intubation quality score (IDS-3) values, median Cormack-Lehane score values and median (POGO) score values, In the operating theatre (within 5 minutes after induction of anesthesia) compared between the three study groups: median time between start of pre-oxygenation, administration of hypnotic (start of anesthetic induction), administration of NMB, initiation of first laryngoscopy and tracheal intubation (defined as the 6th capnography curve) (minutes), In the operating theatre (within 5 minutes after induction of anesthesia) compared between the three study groups: median value of heart rate, mean arterial pressure, SpO2 measured every minute from pre-oxygenation during the first 5 minutes after anesthetic induction, n the operating theatre (within 5 minutes after induction of anesthesia) compared between the three study groups: percentage of patient with pulmonary aspiration of gastric contents, In the operating theatre (within 5 minutes after induction of anesthesia) compared between the three study groups: percentage of patient with moderate (SpO2 ≤ 95%) or severe (SpO2 ≤ 80%) desaturation during the first 5 minutes after anesthetic induction, In the operating theatre (within 5 minutes after induction of anesthesia) compared between the three study groups: median minimal value of SpO2 value during the first 5 minutes after anesthetic induction, In the operating theatre (within 5 minutes after induction of anesthesia) compared between the three study groups: percentage of patients with major cardio-vascular events: major hemodynamic instability defined as mean arterial pressure ≤ 60mmHg (or ≤ 40% from the patient’s reference value) [16], heart rate < 45/mn, or systolic arterial pressure < 80 mmHg, cardiac arrythmia requiring pharmacological or external electric intervention or lasting more than 30 seconds, In the operating theatre (within 5 minutes after induction of anesthesia) compared between the three study groups: percentage of patients with anaphylaxis reaction (Grade of anaphylaxis reaction), In the operating theatre (within 5 minutes after induction of anesthesia) compared between the three study groups: rates of vasopressor use and volume of intravenous fluids for vascular filling (from entry into the operating theatre to induction and from induction to recovery room), In the operating theatre (within 5 minutes after induction of anesthesia) compared between the three study groups: the total dose of hypnotic used during the first 5 minutes after anesthetic induction, In the recovery room compared between the three study groups: postoperative Nu-DESC score median value, In the recovery room compared between the three study groups: percentage of patient requiring sedative therapy in recovery room assigned with delirium, Up to day 7 compared between the 3 groups: percentage of patient with major cardiovascular complications, Up to day 7 compared between the three study groups: percentage of patient with postoperative acute renal failure at day 7, Up to day 7 compared between the three study groups:intra-hospital mortality, Up to day 7 compared between the three study groups: survival proportion at day 7

Source: https://euclinicaltrials.eu/ctis-public/view/2025-521602-18-00